EU clinical trial 2024-510729-24-00: Interventional, randomized, double-blind, parallel-group, placebo-controlled study of add-on eptinezumab treatment to brief education intervention, for the preventive treatment of migraine in patients with a dual diagnosis of migraine and Medication Overuse Headache.
Protocol code: RESOLUTION 20007A
Sponsor: H. Lundbeck A/S (Pharmaceutical company). Phase: Therapeutic use (Phase IV). Countries: Netherlands (ended), Norway (ended), Germany (ended), Italy (ended), Spain (ended), Denmark (ended), Sweden (ended), France (ended).
Therapeutic area(s): Diseases [C] - Nervous System Diseases [C10]
Gender: Female, Male. Age: 18-64 years, 65+ years. Enrolment: 720.
Status: Ended. Start date (EU): 2022-09-01. End date (EU): 2025-03-13. End date: 2025-04-02. Decision date: 2024-04-02. Results received: Yes. Last updated: 2025-05-27.
Decision dates by country: DK: 2024-04-03, NO: 2024-04-03, DE: 2024-04-08, IT: 2024-04-09, SE: 2024-04-08, FR: 2024-04-03, ES: 2024-04-05, NL: 2024-04-02

Condition(s): Chronic Migrane, Migrane, Medication Overuse Headache
Product: VYEPTI 100 mg concentrate for solution for infusion

Primary endpoint: Change from baseline in the number ofMHDs (Weeks 1-4)
Endpoint(s): Change from baseline in MMDs (Weeks 1-12), Change from baseline in MHDs (Weeks 1-12), Not fulfilling the ICHD-3 diagnostic criteria for CM nor MOH (Week 4), Not fulfilling the ICHD-3 diagnostic criteria for CM nor MOH (Week 12), Change from baseline in average Daily Pain assessment score (Weeks 1-2), Change from baseline in monthly days with acute medication use (Weeks 1-4), Change from baseline in monthly days with acute medication use (Weeks 1-12, Change from baseline in the number ofMHDs (Weeks 1-4)

Source: https://euclinicaltrials.eu/ctis-public/view/2024-510729-24-00